EU clinical trial 2023-505222-34-00: An Open-Label, Multi-Center, Phase Ib/II Study of Glofitamab and Atezolizumab or Polatuzumab Vedotin (Plus A Single Pretreatment Dose of Obinutuzumab) in Adult Patients with Relapsed/Refractory B-Cell Non-Hodgkin’s Lymphoma
Protocol code: NP39488
Sponsor: F. Hoffmann-La Roche AG (Pharmaceutical company). Phase: Phase I and Phase II (Integrated)- First administration to humans. Countries: Italy (ongoing, recruitment ended), Belgium (ongoing, recruitment ended), Denmark (ongoing, recruitment ended), Spain (ongoing, recruitment ended).
Therapeutic area(s): Diseases [C] - Neoplasms [C04]
Gender: Female, Male. Age: 18-64 years, 65+ years. Enrolment: 173.
Status: Ongoing, recruitment ended. Start date (EU): 2018-04-23. Decision date: 2024-03-15. Results received: No. Last updated: 2026-03-31.
Decision dates by country: DK: 2024-03-15, BE: 2024-03-29, IT: 2024-03-20, ES: 2024-03-18

Condition(s): Relapsed/refractory (r/r) B-cell Non-Hodgkin’s Lymphoma (NHL)

Primary endpoint: 1. Best ORR (CR or PR) based on PET-CT and/or CT scan as determined by the IRC using Lugano 2014 criteria, 2. Incidence and nature of dose-limiting toxicities (DLTs) during the DLT observation period
Endpoint(s): 1. Best ORR (CR or PR at any time in the study) based on PET-CT and/or CT scan, as determined by the investigator, 2. Best CR rate on study based on PET-CT and/or CT scan, as determined by the investigator and IRC, 3. DOCR, defined as the time from the first occurrence of a documented complete response to disease progression \ or death from any cause, whichever occurs first as determined by the investigator and IRC, 4. DOR, defined as the time from the first occurrence of a documented objective response to disease progression as determined by the investigator and IRC, 5. PFS, defined as the time from first study treatment to the first occurrence of disease progression, or death from any cause, whichever occurs first as determined by the investigator and IRC, 6. EFS, defined as the time from first study treatment to the first occurrence of disease progression, or relapse initiation of NALT, or death from any cause, whichever occurs first, determined by the investigator and IRC, 7. Time to first complete response (TFCR), defined as time from the start of treatment to the first CR among complete responders, determined by the investigator and IRC, 8. Time to first overall response (TFOR), defined as the first treatment to first response among responders, determined by the investigator and IRC, 9. OS, defined as the time from first study treatment to death from any cause, 10. Incidence, nature, frequency, severity, and timing of AEs and serious adverse events (SAEs) graded according to National Cancer Institute Common Terminology Criteria for Adverse Events version 4, 11. Incidence and severity of CRS following glofitamab administration, with severity determined according to ASTCT criteria (Lee et al. 2019; Appendix 6), 12. Changes in vital signs, electrocardiograms, and clinical laboratory results during and following study treatment administration, 13. Incidence of anti-drug antibody formation, 14. Elimination half-life, 15. Total serum exposure - Area under the concentration-time curve, 16. Time to maximum observed serum concentration, 17. Maximum serum concentration observed, 18. Minimum serum concentration under steady-state conditions within a dosing interval, 19. Other PK parameters such as clearance (CL), and volume of distribution at steady state (Vss), may also be calculated as data allow., 20. CD8-positive T-cell proliferation in tumor tissue and blood, 21. B-cell reduction in blood and tumor tissue

Source: https://euclinicaltrials.eu/ctis-public/view/2023-505222-34-00